EU clinical trial 2024-513290-53-00: A Phase II randomized trial of RSV vaccination in allogeneic hematopoietic stem cell transplant recipients (RSV-Allo study)
Sponsor: Centre hospitalier universitaire de Liege (Hospital/Clinic/Other health care facility). Phase: Phase II and Phase III (Integrated). Countries: Belgium (ongoing, recruiting).
Therapeutic area(s): Diseases [C] - Immune System Diseases [C20]; Diseases [C] - Hemic and Lymphatic Diseases [C15]
Gender: Female, Male. Age: 18-64 years, 65+ years. Enrolment: 204.
Status: Ongoing, recruiting. Start date (EU): 2024-11-07. Decision date: 2024-10-10. Results received: No. Last updated: 2025-05-05.

Condition(s): allogeneic - Hematopoietic Stem Cell Transplantation
Product: Arexvy powder and suspension for suspension for injection Respiratory Syncytial Virus (RSV) vaccine (recombinant, adjuvanted), Abrysvo powder and solvent for solution for injection Respiratory syncytial virus vaccine (bivalent, recombinant)

Primary endpoint: First co-primary endpoint : The primary endpoint will be to assess the efficacy of the each RSVpreF and RSVpreF3 OA vaccines in allo-HSCT recipients. We will use the surrogate marker of seroconversion (see section 7.3 for the definition of response) for assessing vaccine efficacy. Efficacy will be defined as a seroconversion rate > 80% with either one or two doses of the vaccine., Second co-primary endpoint : To define a baseline signature predicting response to RSVpreF and RSVpreF3 OA vaccines using systems vaccinology tools.

Source: https://euclinicaltrials.eu/ctis-public/view/2024-513290-53-00